EU clinical trial 2023-509311-91-01: A randomized, double-blind, placebo-controlled Phase 2 study using the rhinovirus challenge model to investigate the efficacy and safety of 2-Deoxy-D-glucose as pre-exposure prophylaxis.
Protocol code: 2-DG-02
Sponsor: G.ST Antivirals GmbH (Pharmaceutical company). Phase: Therapeutic exploratory (Phase II). Countries: Netherlands (ended).
Therapeutic area(s): Diseases [C] - Virus Diseases [C02]
Gender: Female, Male. Age: 18-64 years. Enrolment: 128.
Status: Ended. Start date (EU): 2024-02-15. End date (EU): 2024-08-13. Decision date: 2024-02-14. Results received: Yes. Last updated: 2024-02-14.

Condition(s): Rhinovirus-associated illness
Product: Placebo for 2-deoxy-D-glucose, 2-deoxy-D-glucose

Primary endpoint: The difference in the rate of rhinovirus-associated illness between 2-DG and placebo
Endpoint(s): Difference in number of infected subjects (defined by laboratory-confirmed infection), Difference in % of infected subjects (defined by laboratory-confirmed infection), Difference in Total Jackson Symptom Score, Difference in Duration of Illness between the groups, days 2-15, Occurrence of adverse events (AEs) and adverse drug reactions (ADRs)

Source: https://euclinicaltrials.eu/ctis-public/view/2023-509311-91-01